EU clinical trial 2024-517783-37-00: The safety of ticagrelor monotherapy after primary percutaneous coronary intervention for ST-elevation myocardial infarction and the effect on intramyocardial haemorrhage
Sponsor: Radboud universitair medisch centrum Stichting (Hospital/Clinic/Other health care facility). Phase: Therapeutic use (Phase IV). Countries: Netherlands (ongoing, recruiting).
Therapeutic area(s): Phenomena and Processes [G] - Circulatory and Respiratory Physiological Phenomena [G09]
Gender: Female, Male. Age: 18-64 years, 65+ years. Enrolment: 200.
Status: Ongoing, recruiting. Start date (EU): 2024-09-20. Decision date: 2024-09-20. Results received: No. Last updated: 2024-09-20.

Condition(s): ST elevation myocardial infarction (STEMI)
Product: Acetylsalicylzuur Aurobindo cardio 80 mg, tabletten.

Primary endpoint: Composite of major adverse cardiac and cerebral events (MACCE), consisting of: Myocardial infarction; Stent thrombosis; Ischemic stroke;Cardiovascular mortality., Infarct size and size of IMH determined by CMR at day 5-8 post-PPCI.
Endpoint(s): Bleeding complications BARC ≥ 2, All-cause mortality, To compare platelet reactivity between ticagrelor monotherapy and ticagrelor + ASA., To assess the anti-inflammatory effects of ticagrelor with or without aspirin on the inflammation response elicited by the myocardial infarction., To assess coagulation factors after the myocardial infarction in patients using ticagrelor with or without aspirin.

Source: https://euclinicaltrials.eu/ctis-public/view/2024-517783-37-00